EU clinical trial 2024-513450-30-00: EORTC protocol 1414-ROG-GUCG: Phase IIIb randomized trial comparing irradiation plus long-term adjuvant androgen deprivation with GnRH antagonist versus GnRH agonist plus flare protection in patients with very high risk localized or locally advanced prostate cancer. A joint study of the EORTC ROG and GUCG. Pegasus
Protocol code: 1414-ROG-GUCG
Sponsor: Europese Organisatie Voor Onderzoek En Behandeling Van Kanker Organisation Europeenne Pour La Recherche Et Le Traitement Du Cancer European Organi (Patient organisation/association). Phase: Therapeutic confirmatory (Phase III). Countries: Germany (ended), Belgium (ended), Spain (ended).
Therapeutic area(s): Diseases [C] - Neoplasms [C04]
Gender: Male. Age: 18-64 years, 65+ years. Enrolment: 476.
Status: Ended. Start date (EU): 2017-09-25. End date (EU): 2026-08-03. End date: 2026-08-04. Decision date: 2024-08-07. Results received: No. Last updated: 2026-02-11.
Decision dates by country: BE: 2024-08-12, DE: 2024-08-14, ES: 2024-08-07

Condition(s): very high risk localized or locally advanced prostate cancer
Product: DEGARELIX, GOSERELIN, TRIPTORELIN, LEUPRORELIN ACETATE, DEGARELIX, DEGARELIX, TRIPTORELIN, DEGARELIX, LEUPRORELIN ACETATE, TRIPTORELIN

Primary endpoint: The primary endpoint is the proportion of patients with PSA nadir < 0.1 ng/mL within 6 months following completion of RT.
Endpoint(s): 1. Clinical progression-free survival, 2. Time to next systemic anticancer therapy, 3. Time to next systemic anticancer therapy other than ADT, 4. Proportion of patients switching from GnRH antagonists to GnRH agonists and total effective duration of treatment with the originally allocated drug., 5. Overall survival, 6. Prostate Cancer specific survival, 7. PSA, 8. The incidence of clinical cardiovascular events – CCE (i.e. arterial embolic or thrombotic events, hemorrhagic or ischemic cerebrovascular conditions, myocardial infarction, and other ischemic heart disease) in patients who had cardiovascular events before entering the trial and in those without such events., 9. The incidence of urinary tract infection, 10. Patient reported outcomes: (a) International Prostate Symptoms Score (I-PSS) (urinary symptoms); (b) Quality of Life (HRQoL) measured with EORTC QLQ-C30 and PR25 instruments with the overall health related quality of life scale as primary scale; (c) EQ-5L (to enable a future health economics analysis), 11. Progression free survival defined as the time in days from randomization to death, clinical or biochemical progression or to the start of another line of systemic anti-neoplastic therapy in absence of progression or further systemic antineoplastic therapy, whichever comes first

Source: https://euclinicaltrials.eu/ctis-public/view/2024-513450-30-00